EU clinical trial 2022-503102-20-00: A Study of ZL-1218 with or without Pembrolizumab in Subjects with Advanced Solid Tumor Cancers to Find a Suitable Dose and to Test How Different Doses of these Medications can be Tolerated by the Body
Protocol code: ZL-1218-001
Sponsor: Zai Lab (Shanghai) Co. Ltd. (Pharmaceutical company). Phase: Human Pharmacology (Phase I)- First administration to humans. Countries: Spain (ended).
Therapeutic area(s): Diseases [C] - Neoplasms [C04]
Gender: Female, Male. Age: 18-64 years, 65+ years. Enrolment: 40.
Status: Ended. Start date (EU): 2025-03-10. End date (EU): 2025-08-28. Decision date: 2023-08-28. Results received: No. Last updated: 2025-04-01.

Condition(s): Advanced solid tumors

Source: https://euclinicaltrials.eu/ctis-public/view/2022-503102-20-00